EU clinical trial 2025-522701-38-00: EFFICACY OF FARICIMAB IN PATIENTS WITH SUBRETINAL HYPERREFLECTIVE MATERIAL ASSOCIATED WITH TYPE 2 OR MIXED NEOVASCULAR MEMBRANES ASSESSED BY MULTIMODAL IMAGING
Protocol code: FARIDUO
Sponsor: Asociacion Instituto De Investigacion Sanitaria Biobizkaia (Laboratory/Research/Testing facility). Phase: Therapeutic use (Phase IV). Countries: Spain (ongoing, recruiting).
Therapeutic area(s): Diseases [C] - Eye Diseases [C11]
Gender: Female, Male. Age: 18-64 years, 65+ years. Enrolment: 100.
Status: Ongoing, recruiting. Start date (EU): 2026-02-26. Decision date: 2025-12-15. Results received: No. Last updated: 2026-05-14.

Condition(s): SUBRETINAL HYPERREFLECTIVE MATERIAL
Product: Vabysmo 120 mg/mL solution for injection in pre-filled syringe

Primary endpoint: Resolution of SHRM at week 16

Source: https://euclinicaltrials.eu/ctis-public/view/2025-522701-38-00